EU clinical trial 2024-520107-12-00: A Phase 3b, Multicenter, Rollover Study for Participants Previously Enrolled in Clinical Trials of Povorcitinib
Protocol code: INCB054707-801
Sponsor: Incyte Corp. (Pharmaceutical company). Phase: Therapeutic confirmatory (Phase III). Countries: Italy (ongoing, recruiting), France (ongoing, recruiting), Greece (ongoing, recruiting), Germany (ongoing, recruiting), Denmark (authorised, recruitment pending), Netherlands (ongoing, recruiting), Austria (authorised, recruiting), Spain (ongoing, recruiting), Poland (ongoing, recruiting), Belgium (ongoing, recruiting), Czechia (authorised, recruitment pending), Hungary (authorised, recruitment pending), Bulgaria (ongoing, recruiting).
Therapeutic area(s): Diseases [C] - Skin and Connective Tissue Diseases [C17]
Gender: Female, Male. Age: 18-64 years, 65+ years. Enrolment: 863.
Start date (EU): 2025-09-03. Decision date: 2025-08-26. Results received: No. Last updated: 2026-07-31.
Decision dates by country: DK: 2025-08-26, HU: 2025-08-29, AT: 2025-08-31, GR: 2025-08-26, DE: 2025-08-27, FR: 2025-08-26, IT: 2025-08-26, BE: 2025-08-26, NL: 2025-11-07, BG: 2025-09-01, ES: 2025-08-27, PL: 2025-08-29, CZ: 2025-11-13

Condition(s): Hidradenitis Suppurativa // Prurigo Nodularis // Vitiligo
Product: Povorcitinib, Povorcitinib, Povorcitinib

Primary endpoint: TEAEs reported in participants receiving povorcitinib
Endpoint(s): For HS indication: ANdT count of 0-2 at each visit, For vitiligo indication: Change from baseline of the initial parent study (INCB 54707-303 or INCB 54707-304) in F-VASI score at each visit, For vitiligo indication: Change from baseline of the initial parent study (INCB 54707-303 or INCB 54707-304) in T-VASI score at each visit, For PN indication: Itch NRS score of 0 or 1 at each visit, For PN indication: IGA-CPG-S score of 0 or 1 at each visit

Source: https://euclinicaltrials.eu/ctis-public/view/2024-520107-12-00